EU clinical trial 2024-511292-15-00: Biomarker Phase II Study Of Cabozantinib In Advanced Radioactive-Iodine Refractory Differentiated Thyroid Cancer.
Protocol code: GETNE-T2216
Sponsor: Grupo Espanol De Tumores Neuroendocrinos (Patient organisation/association). Phase: Therapeutic exploratory (Phase II). Countries: Spain (ended).
Therapeutic area(s): Diseases [C] - Neoplasms [C04]
Gender: Female, Male. Age: 18-64 years, 65+ years. Enrolment: 41.
Status: Ended. Start date (EU): 2023-05-25. End date (EU): 2025-11-30. Decision date: 2024-03-05. Results received: No. Last updated: 2024-03-05.

Condition(s): Advance Radioactive-Iodine Refractory Differentiated Thyroid Cancer
Product: CABOMETYX 60 mg film-coated tablets, CABOMETYX 20 mg film-coated tablets, CABOMETYX 40 mg film-coated tablets

Primary endpoint: The primary endpoint for this biomarker-focused trial is the determination of cfCHIP-seq on isolated chromatin nucleosomes from blood samples extracted to patients with DTC at baseline, before any dose of study treatment, after 24 weeks of treatment, at the end of treatment, at the beginning of new line of treatment if started >3 months after the end of treatment.
Endpoint(s): The molecular biomarkers at baseline will be crossed with the following endpoints to find potential prognostic value for cabozantinib efficacy: ● Disease control rate (DCR) ● Duration of Response (DoR) ● Progression-free Survival (PFS) ● Overall Survival (OS), The molecular biomarkers at baseline will be crossed with the following endpoints to find potential prognostic value for cabozantinib safety: Frequency and severity of adverse events and Treatment-related adverse events (TRAEs) assessed by NCI CTCAE v5.0. Frequency of AEs leading to treatment discontinuation. Health-related quality of life (HRQoL), assessed through the European Organization for Research and Treatment of Cancer Quality of Life Questionnaire C30 (EORTC QLQ-C30) version 3

Source: https://euclinicaltrials.eu/ctis-public/view/2024-511292-15-00